EU clinical trial 2024-516969-36-00: A Phase I/IIa Study of ODX (OsteoDex) in Multiple Myeloma
Protocol code: ODX-MM-001
Sponsor: Dextech Medical AB (Pharmaceutical company). Phase: Phase I and Phase II (Integrated)- Other. Countries: Sweden (ended).
Therapeutic area(s): Diseases [C] - Hemic and Lymphatic Diseases [C15]
Gender: Female, Male. Age: 18-64 years, 65+ years. Enrolment: 12.
Status: Ended. Start date (EU): 2024-09-16. End date (EU): 2026-03-02. Decision date: 2024-09-16. Results received: No. Last updated: 2025-10-06.

Condition(s): Multiple Myeloma
Product: OsteoDex

Primary endpoint: The primary endpoint parameters are occurrence of AEs/SAEs, vital signs, physical examination, ECG, and the results of urinalysis and safety laboratory tests (haematology, electrolytes, liver function, and biochemistry including S/P-Creatinine and S/P-Cystatin C). Note that the primary endpoints will be used to confirm the safety and tolerability of ODX in the patient population and no statistical testing will be performed for these endpoints.
Endpoint(s): • Best overall response rate (partial response [PR] or better) reached during the 14-week treatment/follow-up period, as measured by the IMWG response criteria.• Change in the levels of the serum biomarkers M-protein, FLC, CTX, osteocalcin, and bone-specific S ALP from baseline to Weeks 2, 4, 6, 8, 10, 12, and 14.• Quality of Life (QoL) scores, as measured by the EQ-5D-5L assessment tool, from baseline to Weeks 2, 8, and 14

Source: https://euclinicaltrials.eu/ctis-public/view/2024-516969-36-00